EU clinical trial 2022-501561-51-00: "SKYLINE": Tiragolumab and atezolizumab associated with chemotherapy in triple negative breast cancer: A phase II trial
Protocol code: IC 2022-01
Sponsor: Institut Curie (Laboratory/Research/Testing facility, Hospital/Clinic/Other health care facility). Phase: Therapeutic exploratory (Phase II). Countries: France (ongoing, recruitment ended).
Therapeutic area(s): Diseases [C] - Neoplasms [C04]
Gender: Female. Age: 18-64 years, 65+ years. Enrolment: 160.
Status: Ongoing, recruitment ended. Start date (EU): 2024-03-27. Decision date: 2023-06-14. Results received: No. Last updated: 2025-05-07.

Condition(s): Early and metastatic triple negative breast cancer
Product: CARBOPLATINE HOSPIRA 10 mg/ml, solution injectable pour perfusion, Tecentriq 1,200 mg concentrate for solution for infusion, Cyclophosphamide 500 mg Powder for Solution for Injection or Infusion, Doxorubicin Accord Healthcare 2 mg/ml solution à diluer pour perfusion, Tiragolumab, Abraxane 5 mg/ml powder for dispersion for infusion., 68Ga-FAPI-46

Primary endpoint: Cohort A: rate of pathological complete response (pCR) defined as ypT0/Tis ypN0 (i.e., no invasive residual in breast or nodes; as centrally assessed at the time of definitive surgery). Cohort B: 6 months progression-free survival rate (6 months-PFS), defined as the proportion of patients without progression (as assessed by central review per Positron Emission Tomography Response Evaluation Criteria in Solid Tumors (PERCIST) v1.0) or death within 6 months after the date of inclusion.
Endpoint(s): SAEs (serious adverse events) and AEs (adverse events) according to NCI CTCAE v5.0, by grade and their relationship to atezolizumab and/or tiragolumab and/or chemotherapy., Alternative definition of pCR rate: - ypT0 ypN0 - Residual cancer burden (RCB) - 3 years-iDFS (invasive disease-free survival) - ORR (objective response rate) - DoR (duration of response) - 6-month-CBR (clinical benefit rate) - OS (overall survival), The 5 Dimension 5 Level (EQ-5D-5L) scale measured at different timepoints. The measures of interest are: - The mean difference in the change from baseline to different timepoints in total/subscale scores. - Time to deterioration in pain, physical functioning, and role functioning and global health status/QoL., Relationship between clinical characteristics, efficacy outcomes and candidate (bio)markers of response, which may include, but are not limited to: - proteins (PD-L1 expression…), - RNA and DNA analyses, omics analysis in tumor tissues or blood (ctDNA…), - functional imaging (PET/CT) analysis - combination of the biomarkers mentioned above, such as omics - combination of the biomarkers mentioned above, such as omics data, ctDNA, 68Ga-FAPI and 18F-FDG., Comparison of 68Ga-FAPI PET/CT and 18F-FDG PET/CT prognostic performances, separately and combined., To determine which criteria for response assessment (PERCIST 1.0 versus PERCIMT) are most directly correlated to clinical outcomes., Quantitative and qualitative analyses of circulating tumor DNA (ctDNA) collected at baseline and during therapy. - Analysis of combined detection of ctDNA, 68Ga-FAPI and 18F-FDG-PET/CT.

Source: https://euclinicaltrials.eu/ctis-public/view/2022-501561-51-00